EU clinical trial 2025-520564-17-00: A Phase 3, multicenter, open-label extension study to evaluate the long-term safety, tolerability, and efficacy of subcutaneous sonelokimab in participants with moderate to severe hidradenitis suppurativa
Protocol code: M1095-HS-303
Sponsor: MoonLake Immunotherapeutics AG (Pharmaceutical company). Phase: Therapeutic confirmatory (Phase III). Countries: Norway (ongoing, recruitment ended), Hungary (ongoing, recruitment ended), Spain (ongoing, recruitment ended), France (ongoing, recruitment ended), Germany (ongoing, recruitment ended), Poland (ongoing, recruitment ended), Czechia (ongoing, recruitment ended), Slovakia (ongoing, recruitment ended), Bulgaria (ongoing, recruitment ended), Netherlands (ongoing, recruitment ended), Italy (ongoing, recruitment ended), Portugal (ongoing, recruitment ended), Belgium (ongoing, recruitment ended).
Therapeutic area(s): Diseases [C] - Skin and Connective Tissue Diseases [C17]
Gender: Female, Male. Age: 18-64 years, 65+ years. Enrolment: 492.
Status: Ongoing, recruitment ended. Start date (EU): 2025-10-16. Decision date: 2025-08-29. Results received: No. Last updated: 2026-07-28.
Decision dates by country: BG: 2025-09-01, CZ: 2025-09-03, FR: 2025-09-03, HU: 2025-09-02, NL: 2025-09-02, NO: 2025-09-01, PL: 2025-09-08, SK: 2025-09-01, ES: 2025-09-03, BE: 2025-11-24, PT: 2025-10-29, IT: 2025-09-02, DE: 2025-09-01

Condition(s): Hidradenitis suppurativa (HS)
Product: Sonelokimab

Primary endpoint: 1. Treatment-emergent adverse event (TEAEs), 2. Serious adverse event (SAEs), 3. TEAEs leading to study withdrawal, 4. Adverse event of special interest (AESIs), 5. Vital signs, and ECG results, 6. Abnormal laboratory parameters (hematology, clinical chemistry)

Source: https://euclinicaltrials.eu/ctis-public/view/2025-520564-17-00